EU clinical trial 2024-516732-97-00: AMANTADINE AND TRANSCRANIAL MAGNETIC TRANSCRANIAL MAGNETIC STIMULATION FOR FATIGUE IN MULTIPLE SCLEROSIS: A PHASE III, CONTROLLED, RANDOMISED, DOUBLE-BLIND, CROSSOVER TRIAL
Protocol code: FETEM
Sponsor: Fundacion Para La Investigacion Biomedica Del Hospital Clinico San Carlos (Laboratory/Research/Testing facility). Phase: Therapeutic confirmatory (Phase III). Countries: Spain (ongoing, recruitment ended).
Therapeutic area(s): Diseases [C] - Nervous System Diseases [C10]
Gender: Female, Male. Age: 18-64 years, 65+ years. Enrolment: 144.
Status: Ongoing, recruitment ended. Start date (EU): 2022-11-28. Decision date: 2024-09-11. Results received: No. Last updated: 2024-09-11.

Condition(s): multiple sclerosis (MS)
Product: Amantadine Level 100 mg cápsulas duras

Primary endpoint: The change in the values of the MFIS questionnaire is considered as the main study variable for the evaluation of effectiveness.
Endpoint(s): - Patient-perceived quality of life. The change in the mean score of the patient-perceived quality of life scale (SF-12) between the time of inclusion in the study and at the beginning and end of each phase will be assessed. - Beck Depression Inventory-II to assess depressive symptomatology. The assessment will be made at inclusion, and at the beginning and end of each phase. - Total costs per patient. Total costs of hospitalisation and treatment as well as other health care will be measured. -

Source: https://euclinicaltrials.eu/ctis-public/view/2024-516732-97-00